EU clinical trial 2023-503574-20-00: Diagnostic Accuracy Study for OWL-EVO1 as a Lung Cancer EVOC® Probe
Protocol code: OML-EV2-2.1_EU
Sponsor: Owlstone Medical Limited (Pharmaceutical company). Phase: Therapeutic exploratory (Phase II). Countries: Hungary (ongoing, recruitment ended), Czechia (ongoing, recruitment ended).
Therapeutic area(s): Diseases [C] - Neoplasms [C04]
Gender: Female, Male. Age: 18-64 years, 65+ years. Enrolment: 100.
Status: Ongoing, recruitment ended. Start date (EU): 2023-11-29. Decision date: 2023-11-08. Results received: No. Last updated: 2025-03-10.
Decision dates by country: CZ: 2023-11-08, HU: 2023-11-08

Condition(s): Lung Cancer

Primary endpoint: Diagnostic accuracy: Diagnostic accuracy will be reported using a Receiver Operator Characteristic (ROC) curve and Area Under the Curve (AUC), as well as negative predictive value (NPV), positive predictive value (PPV), Sensitivity and Specificity. Metrics will be reported for overall test performance at all timepoints as well as pre-defined subgroup analyses.
Endpoint(s): Optimised test: Locked down protocol for breath sampling through evaluation of method, sampling timepoints, posture and duration of breath samples and determination of OWL-EVO1 dose. This optimised test will then be used to assess the primary objective., Safety and tolerability: Refined understanding of safety and tolerability of OWL-EVO1 based on reported Adverse Events associated with probe administration

Source: https://euclinicaltrials.eu/ctis-public/view/2023-503574-20-00